EU clinical trial 2023-507201-34-00: "Multicenter randomized clinical trial to evaluate the cardioverter capacity of amiodarone pre-electrical cardioversion in persistent atrial fibrillation"
Protocol code: PERIVERSION
Sponsor: Institut D Investigacio Sanitaria Pere Virgili (Hospital/Clinic/Other health care facility). Phase: Therapeutic use (Phase IV). Countries: Spain (ongoing, recruiting).
Therapeutic area(s): Diseases [C] - Cardiovascular Diseases [C14]
Gender: Female, Male. Age: 18-64 years, 65+ years. Enrolment: 130.
Status: Ongoing, recruiting. Start date (EU): 2025-01-23. Decision date: 2024-08-30. Results received: No. Last updated: 2024-08-30.

Condition(s): Atrial fibrillation
Product: Trangorex 200 mg comprimidos

Primary endpoint: Efficacy of amiodarone in reversion to sinus rhythm before electrical cardioversion in persistent atrial fibrillation.
Endpoint(s): 1) time from initiation of amiodarone to reversion to sinus rhythm; 2) maintenance of sinus rhythm during the month after electrical cardioversion.

Source: https://euclinicaltrials.eu/ctis-public/view/2023-507201-34-00